EU clinical trial 2023-506713-22-00: An open-label sleep laboratory study of efficacy and safety of piromelatine in a well-defined population of patients with idiopathic (isolated) Rapid Eye Movement Behavior Disorder (iRBD).
Protocol code: Piromelatine PSG-RBD
Sponsor: Neurim Pharmaceuticals (1991) Ltd. (Pharmaceutical company). Phase: Therapeutic exploratory (Phase II). Countries: Austria (ended).
Therapeutic area(s): Diseases [C] - Nervous System Diseases [C10]
Gender: Female, Male. Age: 18-64 years, 65+ years. Enrolment: 12.
Status: Ended. Start date (EU): 2024-03-05. End date (EU): 2025-08-11. End date: 2025-08-12. Decision date: 2024-01-29. Results received: Yes. Last updated: 2024-12-18.

Condition(s): idiopathic (isolated) Rapid Eye Movement Behavior Disorder
Product: Piromelatine (Neu-P11)

Primary endpoint: iRBD severity assessed by vPSG performed according to the AASM recommendations, with the addition of electromyography of both FDS muscles in the upper limbs (optional according to the AASM recommendations) and scored by a composite measure of motor events, iRBD episodes, and vocalizations frequency and severity as recommended by the IRBDSG, RSWA quantified in the chin (phasic, tonic, and any muscle activity) and in the FDS (phasic muscle activity) on 3-second mini-epochs (manually identified) according to the [CCI], using a validated algorithm, with manual artifact correction after automatic analysis, [CCI], Sleep hypnographic variables (SL, WASO, TST, SE, % of N1, N2, N3 and REM sleep) scored in accordance with the AASM, EEG power spectral analysis during REM/NREM sleep, PSQI score, ESS score, Relationship between response/no response and the presence of [CCI]. For that reason, blood samples of all enrolled patients will undergo [CCI]., Safety parameters (vital signs, physical examination, AEs, SAEs, laboratory assessments, and ECG)
Endpoint(s): iRBD severity assessed by vPSG with the addition of electromyography of both FDS muscles in the upper limbs (optional according to the AASM recommendations), RSWA quantified in the chin (phasic, tonic, and any muscle activity) and in the FDS (phasic muscle activity), [CCI], Sleep hypnographic variables (SL, WASO, TST, SE), PSQI score, ESS score, [CCI], [CCI], RSWA quantified in the chin (phasic, tonic, and any muscle activity) and in the FDS (phasic muscle activity), EEG power spectral analysis during REM/NREM sleep, MoCA, [CCI], [CCI], [CCI], Safety parameters (vital signs, physical examination, AEs, SAEs, laboratory assessments, and ECG)

Source: https://euclinicaltrials.eu/ctis-public/view/2023-506713-22-00